EU clinical trial 2023-508435-31-00: First-in-Human Study of OKI-219 Alone and in Combination with Other Therapies in Patients with Solid Tumors / Breast Cancer
Protocol code: OKI-219-101
Sponsor: Onkure Inc. (Pharmaceutical company). Phase: Human Pharmacology (Phase I)- First administration to humans. Countries: Belgium (ongoing, recruiting), Spain (ongoing, recruiting), Italy (ongoing, recruiting), France (ongoing, recruiting).
Therapeutic area(s): Diseases [C] - Neoplasms [C04]
Gender: Female, Male. Age: 18-64 years, 65+ years. Enrolment: 145.
Status: Ongoing, recruiting. Start date (EU): 2024-08-09. Decision date: 2024-04-18. Results received: No. Last updated: 2026-07-03.
Decision dates by country: IT: 2024-04-23, FR: 2024-04-23, ES: 2024-04-19, BE: 2024-04-18

Condition(s): Advanced Solid Tumors, Advanced Breast Cancer

Source: https://euclinicaltrials.eu/ctis-public/view/2023-508435-31-00